EU clinical trial 2024-514603-34-00: Multicentric phase III trial comparing two strategies in intermediate-risk differentiated thyroid cancer patients: Systematic radioiodine administration versus decision of radioiodine treatment guided by a post-operative work-up based on serum Tg values and diagnostic RAI scintigraphy
Protocol code: INTERMEDIATE-01
Sponsor: Centre Francois Baclesse (Hospital/Clinic/Other health care facility). Phase: Therapeutic confirmatory (Phase III). Countries: France (ongoing, recruiting).
Therapeutic area(s): Diseases [C] - Neoplasms [C04]
Gender: Female, Male. Age: 18-64 years, 65+ years. Enrolment: 368.
Status: Ongoing, recruiting. Start date (EU): 2020-03-02. Decision date: 2024-06-24. Results received: No. Last updated: 2026-06-22.

Condition(s): intermediate-risk differentiated thyroid cancer patients
Product: Theracap 131, capsules 37-5550 MBq/st, THERACAP131, Iodure (131I) de sodium pour thérapie, gélule

Primary endpoint: - The primary endpoint is the rate of patients with excellent response (normal neck ultrasonography and Tg/LT4 <0.2 ng/mL and absence of TgAb and if performed, no abnormalities on other imaging modalities), at 3 years post-randomization
Endpoint(s): - Excellent response rate at 1 and 5 years post-randomization, defined as above, will be used for non-inferiority comparison using the 2015 ATA recommendations, - The scores on HRQoL, anxiety and fear of cancer recurrence will be calculated according to the corresponding scoring manual from the various questionnaires at inclusion, end of diagnostic assessment, end of treatment (for treated patients), 1 year and 3 years. The lachrymal, nasal and salivary glands toxicities will be evaluated from specific questionnaires at inclusion, end of diagnostic assessment, end of treatment (for treated patients), 1 year and 3 years, - Supplemental treatments (surgery, RAI administration or others) performed within 5 years post-randomization in both groups. The response to these treatments will be defined according to the 2015 ATA guidelines: excellent response, biochemical incomplete response, structural incomplete response, and indeterminate response, - Costs within 5 years post-randomization in both groups, from the French collective perspective, taking into account the resources such as: • External consultations, hospitalizations • Imaging exams (neck-US, scintigraphy, CT scans…) • Biological exams • Transportation related to the care • Study treatments: I131 and rhTSH • Treatment for possible recurrence (surgery, RAI administration or others) • Sick leave related to thyroid cancer, - The results of diagnostic and post-therapeutic scintigraphy (in the guided follow-up group), - The proportion of patients for whom the results of the diagnostic RAI scintigraphy have changed the decision-making for RAI treatment (in the guided follow-up group), - The post-operative serum Tg levels on Levothyroxine treatment (Tg/LT4) and after rhTSH (Tg/rhTSH) to assess their predictive value on the presence of RAI-avid lesions in the RAI group and on the rate of excellent response at 3 years in both groups, - The excellent response rate at 3 and 5 years after randomization in case of supplemental treatments, - The predictive values of somatic molecular markers (especially BRAF and TERTp) on the risk of persistent disease, - Excellent response at 1, 3 and 5 years using the new 2025 ATA guidelines [31] or using a Tg cutoff at 1 ng/ml from the Estimabl 2 study [32] in patients treated by thyroidectomy +/- neck dissection without RAI therapy.

Source: https://euclinicaltrials.eu/ctis-public/view/2024-514603-34-00